EU clinical trial 2023-504260-42-00: A Phase 1 Study to Investigate the Effect of Food on the Bioavailability of a Single Cytisinicline 3 mg Tablet and Evaluation of the Pharmacokinetics of Multiple 3 mg Doses (Three Times Daily) in Healthy Adult Smokers
Protocol code: ACH-CYT-11
Sponsor: Achieve Life Sciences Inc. (Pharmaceutical company). Phase: Human Pharmacology (Phase I)- Other. Countries: Portugal (ended).
Therapeutic area(s): Not possible to specify
Gender: Female, Male. Age: 18-64 years, 65+ years. Enrolment: 30.
Status: Ended. Start date (EU): 2023-08-08. End date (EU): 2023-09-21. Decision date: 2023-07-26. Results received: Yes. Last updated: 2023-10-03.

Condition(s): No medical condition
Product: Cytisinicline

Primary endpoint: Cmax, Tlag, Tmax, Tlast, AUC0-τ, AUC0-t, AUC0–∞, %AUCextrap, λz, t1/2, CL/F and V/F, Cytisinicline Cmax, AUC0-t, and AUC0–∞ geometric least squares mean ratios for fed vs. fasted
Endpoint(s): Days 5-7 (Multiple Dose PK parameters): Ctrough (C5h for Dose 1 and Dose 2, C14h for Dose 3), Day 8 (Multiple Dose PK parameters): For Dose 1, Dose 2 and Dose 3: Cmax, Tmax, AUC0-τ (where τ=5 h for Dose 1 and Dose 2 and τ=14 h for Dose 3), and Ctrough (C5h for Dose 1 and Dose 2, t1/2 for Dose 3 on Day 8 and C14h for Dose 3 collected on Day 9); Accumulation: R(Cmax), R(AUC0-τ); Time Invariance: R(AUC0-τ/AUC0–∞); Time to steady state, Adverse events (AEs), electrocardiogram (ECG), vital signs, and clinical laboratory tests

Source: https://euclinicaltrials.eu/ctis-public/view/2023-504260-42-00